EU clinical trial 2022-502059-79-00: StAtins in Frail oldEr patients with ischemic Stroke or Transient ischemic attack
Sponsor: Amsterdam UMC (Hospital/Clinic/Other health care facility). Phase: Therapeutic use (Phase IV). Countries: Netherlands (not authorised).
Therapeutic area(s): Diseases [C] - Cardiovascular Diseases [C14]
Gender: Female, Male. Age: 65+ years. Enrolment: 1200.
Status: Not authorised. Decision date: 2023-02-07. Results received: No. Last updated: 2023-02-07.

Condition(s): Ischemic stroke or transient ischemic attack
Product: Atorvastatine Accord 10 mg filmomhulde tabletten

Primary endpoint: (1) daily functioning, measured with the The Older Persons and Informal Caregivers Survey Short Form (TOPICS-SF), and (2) health related quality of life, measured using the PROMIS-10 with global mental health and global physical health summary scores, both at two years.
Endpoint(s): Secondary outcomes are daily functioning and hrQoL, both at one year. Other secondary outcomes are: physical functioning, functional outcome, cognition, emotional problems, falls, adverse drug events, cardiovascular risk status (based on clinical tests and lab results), general quality of life, societal costs, incidence of cardiovascular event recurrences and mortality - all at one and two years.

Source: https://euclinicaltrials.eu/ctis-public/view/2022-502059-79-00